EU clinical trial 2023-506296-97-00: A Multicenter, Randomized, Double-Blind Placebo-Controlled Phase 3 Study to Evaluate the Efficacy, Safety and Pharmacokinetics of Deucravacitinib in Adolescent Subjects (12 years to less than 18 years) with Moderate to Severe Plaque Psoriasis
Protocol code: IM011-1128
Sponsor: Bristol-Myers Squibb Services Unlimited Company (Pharmaceutical company). Phase: Therapeutic confirmatory (Phase III). Countries: Germany (ongoing, recruiting), Romania (authorised, recruiting), Italy (ongoing, recruiting), Belgium (ongoing, recruiting), Poland (ongoing, recruiting), Hungary (ongoing, recruiting), Spain (ongoing, recruiting).
Therapeutic area(s): Diseases [C] - Immune System Diseases [C20]
Gender: Female, Male. Age: 0-17 years. Enrolment: 145.
Start date (EU): 2025-10-28. Decision date: 2025-10-08. Results received: No. Last updated: 2026-05-29.
Decision dates by country: HU: 2025-10-10, BE: 2025-10-08, PL: 2025-10-10, DE: 2025-10-08, RO: 2025-10-13, IT: 2025-10-10, ES: 2025-10-09

Condition(s): Moderate to Severe Plaque Psoriasis
Product: Placebo to match deucravacitinib 6mg tablets in bottle, oral use, Placebo to match deucravacitinib 2mg minitablets in sachet, oral use, deucravacitinib, deucravacitinib

Primary endpoint: Efficacy: Participants achieving at least 75% improvement in Psoriasis Area and Severity Index (PASI 75) at Week 16., Efficacy: Participants achieving a sPGA score of 0 (clear) or 1 (almost clear) with at least a 2-point reduction from baseline at Week 16., Safety (LTE): AEs and SAEs through study completion., Safety (LTE): Monitoring of growth, including body weight and height and sexual maturation, through study completion.
Endpoint(s): Efficacy: Participants achieving at least 90% improvement in PASI (PASI 90) Week 16., Efficacy: Change from baseline in PASI at Week 16., Efficacy: Change from baseline in BSA involvement at Week 16., Safety: Treatment emergent AEs and SAEs, laboratory parameters, physical examination, and vital signs through study completion., Safety: Participants with protective titers of antibodies to measles, tetanus, and pertussis at Week 16., Safety: Monitoring of growth including body weight and height, and sexual maturation through study completion., Efficacy (LTE): Participants achieving 75% improvement in PASI (PASI 75) over time through study completion., Efficacy (LTE): Participants achieving an sPGA score of 0 (clear) or 1(almost clear) with at least a 2-point reduction from baseline over time through study completion.

Source: https://euclinicaltrials.eu/ctis-public/view/2023-506296-97-00